EU clinical trial 2024-517075-21-00: Tocotrienol and bevacizumab in metastatic colorectal cancer. A randomized phase II marker trial
Protocol code: Toco-CoR
Sponsor: Lillebaelt Hospital (Hospital/Clinic/Other health care facility). Phase: Therapeutic exploratory (Phase II). Countries: Denmark (ongoing, recruitment ended).
Therapeutic area(s): Diseases [C] - Neoplasms [C04]
Gender: Female, Male. Age: 18-64 years, 65+ years. Enrolment: 74.
Status: Ongoing, recruitment ended. Start date (EU): 2020-06-26. Decision date: 2024-09-27. Results received: No. Last updated: 2024-09-27.

Condition(s): Metastatic Colorectal cancer
Product: CAPECITABINE, FLUOROURACIL, CALCIUM FOLINATE, BEVACIZUMAB, PLACEBO, OXALIPLATIN

Primary endpoint: The rate of progression free patients at six months.

Source: https://euclinicaltrials.eu/ctis-public/view/2024-517075-21-00